EU clinical trial 2023-508955-37-00: B7451015 - A PHASE 3 MULTICENTER, LONG-TERM EXTENSION STUDY INVESTIGATING THE EFFICACY AND SAFETY OF ABROCITINIB, WITH OR WITHOUT TOPICAL MEDICATIONS ADMINISTERED TO SUBJECTS AGED 12 YEARS AND OLDER WITH MODERATE TO SEVERE ATOPIC DERMATITIS
Protocol code: B7451015
Sponsor: Pfizer Inc. (Pharmaceutical company). Phase: Therapeutic confirmatory (Phase III). Countries: Poland (ended), Hungary (ended), Spain (ended).
Therapeutic area(s): Diseases [C] - Skin and Connective Tissue Diseases [C17]
Gender: Female, Male. Age: 0-17 years, 18-64 years, 65+ years. Enrolment: 735.
Status: Ended. Start date (EU): 2018-10-10. End date (EU): 2025-12-22. End date: 2025-12-23. Decision date: 2024-05-17. Results received: Yes. Last updated: 2025-07-18.
Decision dates by country: ES: 2024-05-17, HU: 2024-05-21, PL: 2024-05-20

Condition(s): Moderate to severe atopic dermatitis
Product: Cibinqo 100 mg film-coated tablets, Placebo for Abrocitinib 100mg tablet

Primary endpoint: The incidence of treatment emergent adverse events., The incidence of serious adverse events and adverse events leading to discontinuation., The incidence of clinical abnormalities and change from baseline in clinical laboratory values, electrocardiogram (ECG) measurements, and vital signs.
Endpoint(s): Baseline, for efficacy endpoints, is defined as pre-dose Day 1 in the relevant qualifying Parent study: Response based on achieving the Investigator's Global Assessment (IGA) score of clear (0) or almost clear (1) (on a 5-point scale) and a reduction from baseline of ≥ 2 points at all scheduled time points., Response based on achieving ≥ 50%, ≥ 75%, ≥ 90% and 100% improvement from baseline in the Eczema Area and Severity Index (EASI) total score (EASI-50, EASI-75, EASI-90) and EASI-100 at all scheduled time points., Response based on achieving an improvement ≥ 4 points from baseline in the severity of pruritus NRS at all scheduled time points., Change from baseline in the frequency of itching due to Atopic Dermatitis, Change from baseline of Patient Global Assessment (PtGA) at all scheduled time points., Change from baseline in the percentage Body Surface Area (BSA) affected at all scheduled time points., Change from baseline in Dermatology Life Quality Index (DLQI) or Children's DLQI (CDLQI) at all scheduled time points., Change from baseline in Patient Oriented Eczema Measure (POEM) at all scheduled time points., Change from baseline in Hospital Anxiety and Depression Scale (HADS) at all scheduled time points., Change from baseline of EuroQol Quality of Life 5-Dimension 5-Level Scale (EQ-5D-5L) or EuroQol Quality of Life 5-Dimension Youth Scale (EQ-5D-Y) at all scheduled time points., Steroid-free days at all scheduled time points., Serum hsCRP levels at all scheduled time points., Change in height standard deviation score., The proportion of abnormal bone findings in knee MRI in adolescent subjects exposed to abrocitinib 100 mg and 200 mg QD

Source: https://euclinicaltrials.eu/ctis-public/view/2023-508955-37-00